EU clinical trial 2024-519046-79-00: Chemoimmunotherapy in conjunction with blood-brain-barrier opening in patients with newly diagnosed or relapsed primary central nervous system lymphoma
Sponsor: Oulu University Hospital (Hospital/Clinic/Other health care facility). Phase: Therapeutic exploratory (Phase II). Countries: Finland (authorised, recruitment pending).
Therapeutic area(s): Diseases [C] - Neoplasms [C04]
Gender: Female, Male. Age: 18-64 years, 65+ years. Enrolment: 100.
Status: Authorised, recruitment pending. Decision date: 2024-12-20. Results received: No. Last updated: 2024-12-20.

Condition(s): Primaari aivolymfomaa, ensilinjan hoito tai hoito relapoituneessa tai refraktaarissa taudissa
Product: Etopofos 100 mg pulver till infusionsvätska, lösning, Karboplatin Accord 10 mg/ml koncentrat za otopinu za infuziju, Methotrexate Ebewe, 100 mg/ml, koncentrat till infusionsvätska, lösning, MabThera 100 mg concentrate for solution for infusion, Sendoxan 2 000 mg injektiokuiva-aine, liuosta varten

Primary endpoint: 2 ja 5 ja 10 vuoden seurannan kohdalla elossa olevien potilaiden suhteellinen lukumäärä primaari hoidossa olevilla ja uusiutunutta tautia sairastavilla potilailla.
Endpoint(s): Täydellisten ja osittaisten hoitovasteiden määrä 2 ja 5 ja 10 vuoden seurannan kohdalla tautivapaana olevien potilaiden suhteellinen lukumäärä Hoidon haittavaikutukset ja erityisesti pitkäaikaiset neurologiset haitat.

Source: https://euclinicaltrials.eu/ctis-public/view/2024-519046-79-00